EU clinical trial 2022-501344-14-00: A Multicentre, Randomised, Double-blind, Parallel Group, Placebocontrolled, Time-to-first Asthma Exacerbation Phase III Efficacy and Safety Study of Benralizumab in Paediatric Patients with Severe Eosinophilic Asthma (DOMINICA)
Protocol code: D3250C00024
Sponsor: Astrazeneca AB (Pharmaceutical company). Phase: Therapeutic confirmatory (Phase III). Countries: France (ongoing, recruitment ended), Poland (ended), Germany (ended), Italy (ended), Spain (ended).
Therapeutic area(s): Diseases [C] - Respiratory Tract Diseases [C08]
Gender: Female, Male. Age: 0-17 years. Enrolment: 72.
Start date (EU): 2023-06-05. Decision date: 2023-04-20. Results received: No. Last updated: 2026-07-30.
Decision dates by country: DE: 2023-04-20, PL: 2023-04-24, IT: 2023-04-20, ES: 2023-04-24, FR: 2023-04-21

Condition(s): Paediatric Patients with Severe Eosinophilic Asthma Asthma is a long-term lung disorder that causes airways (the tubes that carry air in and out of the lungs) to become inflamed. Patients with severe asthma are likely to have high levels of eosinophils in their blood. Eosinophils are a type of white blood cell that can cause inflammation and can increase the number of asthma attacks and contribute to the decline of lung function.
Product: Placebo for Benralizumab for clinical trials is a sterile liquid solution presented in an accessorized prefilled syringe (APFS) for subcutaneous injection., Benralizumab, Fasenra 30 mg solution for injection in pre-filled syringe, Placebo for Benralizumab 30 mg/ml for clinical trials is a sterile liquid solution presented in an accessorized prefilled syringe (APFS) for subcutaneous injection. The Placebo accessories are the same as the commercial APFS configuration. Each syringe contains 1.0 mL (nominal).

Primary endpoint: Time to first asthma exacerbation defined as a worsening of asthma requiring: • Use of systemic corticosteroid (or a temporary increase) for at least 3 days; a single depo-injectable dose, OR • An emergency room visit due to asthma OR • Hospitalisation due to asthma
Endpoint(s): Change from baseline, during the DB treatment period, in the following measures: ACQ-IA, Asthma symptom score, Rescue medication use, Night-time awakenings due to asthma, PEF, • Serum benralizumab trough concentration • Anti-benralizumab antibodies, Change from baseline, during the DB treatment period, in PAQLQ-IA total score, Change from baseline, during the DB treatment period, in spirometry, including pre-dose/pre-bronchodilator FEV1 and post-bronchodilator FEV1, The AAER in the DB treatment period, Safety: AEs/SAEs : Occurrence/frequency ; Relationship to the IP as assessed by the investigator ; Intensity ; Seriousness ; Death ; AEs leading to discontinuation of IP ; Vital signs ; Clinical laboratory parameters, the Open-Label Extension;Period: AEs and SAEs, the Open-Label Extension: The AAER in the OLE period

Source: https://euclinicaltrials.eu/ctis-public/view/2022-501344-14-00